EU clinical trial 2024-520068-32-00: EFFectiveness of once-weekly insulin ICodec versus once-daily basal Insulin analogues in an insulin-naïve type 2 diabEtes population in real-world cliNical pracTice- The EFFICIENT pragmatic study
Protocol code: NN1436-7727
Sponsor: Novo Nordisk A/S (Pharmaceutical company). Phase: Therapeutic use (Phase IV). Countries: Germany (authorised, recruitment pending), Italy (authorised, recruitment pending).
Therapeutic area(s): Diseases [C] - Nutritional and Metabolic Diseases [C18]
Gender: Female, Male. Age: 18-64 years, 65+ years. Enrolment: 204.
Status: Authorised, recruitment pending. Decision date: 2025-09-05. Results received: No. Last updated: 2026-03-04.
Decision dates by country: DE: 2025-09-05, IT: 2026-01-12

Condition(s): Type 2 diabetes
Product: Lantus 100 units/ml solution for injection in a cartridge, Lantus 100 units/ml solution for injection in a vial, Toujeo 300 units/ml DoubleStar, solution for injection in a pre-filled pen, Awiqli 700 units/mL solution for injection in pre-filled pen, Levemir FlexPen 100 units/ml solution for injection in pre-filled pen., Toujeo 300 units/ml DoubleStar, solution for injection in a pre-filled pen, Tresiba 200 units/mL FlexTouch solution for injection in pre-filled pen, Tresiba 100 units/mL FlexTouch solution for injection in pre-filled pen, Toujeo 300 units/ml SoloStar, solution for injection in a pre-filled pen, Tresiba 200 units/mL FlexTouch solution for injection in pre-filled pen, Tresiba 200 units/mL FlexTouch solution for injection in pre-filled pen, Lantus SoloStar 100 units/ml solution for injection in a pre-filled pen, Levemir FlexPen 100 units/ml solution for injection in pre-filled pen., Lantus SoloStar 100 units/ml solution for injection in a pre-filled pen, Lantus SoloStar 100 units/ml solution for injection in a pre-filled pen, Lantus SoloStar 100 units/ml solution for injection in a pre-filled pen, Lantus 100 units/ml solution for injection in a vial, Lantus 100 units/ml solution for injection in a cartridge, Awiqli 700 units/mL solution for injection in pre-filled pen, Lantus 100 units/ml solution for injection in a cartridge, Awiqli 700 units/mL solution for injection in pre-filled pen, Lantus SoloStar 100 units/ml solution for injection in a pre-filled pen, Awiqli 700 units/mL solution for injection in pre-filled pen, Tresiba 100 units/mL Penfill solution for injection in cartridge, Toujeo 300 units/ml SoloStar, solution for injection in a pre-filled pen, Lantus 100 units/ml solution for injection in a cartridge, Tresiba 200 units/mL FlexTouch solution for injection in pre-filled pen, Awiqli 700 units/mL solution for injection in pre-filled pen, Awiqli 700 units/mL solution for injection in pre-filled pen, Toujeo 300 units/ml DoubleStar, solution for injection in a pre-filled pen, Levemir FlexPen 100 units/ml solution for injection in pre-filled pen., Toujeo 300 units/ml DoubleStar, solution for injection in a pre-filled pen, Awiqli 700 units/mL solution for injection in pre-filled pen, Toujeo 300 units/ml SoloStar, solution for injection in a pre-filled pen, Tresiba 100 units/mL FlexTouch solution for injection in pre-filled pen, Lantus 100 units/ml solution for injection in a vial, Lantus 100 units/ml solution for injection in a vial, Lantus SoloStar 100 units/ml solution for injection in a pre-filled pen, Tresiba 200 units/mL FlexTouch solution for injection in pre-filled pen, Tresiba 100 units/mL FlexTouch solution for injection in pre-filled pen, Awiqli 700 units/mL solution for injection in pre-filled pen, Tresiba 100 units/mL Penfill solution for injection in cartridge, Lantus 100 units/ml solution for injection in a cartridge, Tresiba 200 units/mL FlexTouch solution for injection in pre-filled pen, Lantus SoloStar 100 units/ml solution for injection in a pre-filled pen, Awiqli 700 units/mL solution for injection in pre-filled pen, Levemir FlexPen 100 units/ml solution for injection in pre-filled pen., Lantus 100 units/ml solution for injection in a cartridge, Toujeo 300 units/ml DoubleStar, solution for injection in a pre-filled pen, Tresiba 100 units/mL FlexTouch solution for injection in pre-filled pen, Toujeo 300 units/ml SoloStar, solution for injection in a pre-filled pen, Awiqli 700 units/mL solution for injection in pre-filled pen, Awiqli 700 units/mL solution for injection in pre-filled pen, Levemir Penfill 100 units/ml solution for injection in cartridge., Levemir Penfill 100 units/ml solution for injection in cartridge., Lantus 100 units/ml solution for injection in a cartridge, Levemir FlexPen 100 units/ml solution for injection in pre-filled pen., Tresiba 200 units/mL FlexTouch solution for injection in pre-filled pen, Lantus SoloStar 100 units/ml solution for injection in a pre-filled pen, Lantus 100 units/ml solution for injection in a vial, Lantus 100 units/ml solution for injection in a cartridge, Awiqli 700 units/mL solution for injection in pre-filled pen, Tresiba 100 units/mL FlexTouch solution for injection in pre-filled pen, Awiqli 700 units/mL solution for injection in pre-filled pen, Awiqli 700 units/mL solution for injection in pre-filled pen, Levemir Penfill 100 units/ml solution for injection in cartridge.

Primary endpoint: Change in HbA1c from baseline week 0 (V2) to week 52 (V6).
Endpoint(s): Adelphi Adherence Questionnaire (ADAQ©) At week 52 (V6)., Change in DTSQs in total treatment satisfaction from baseline week 0 (V2) to week 52 (V6)., TRIM-D compliance domain at week 52 (V6)., TRIM-D treatment burden domain at week 52 (V6)., Number of severe hypoglycaemic episodes (level 3) from baseline week 0 (V2) to week 52 (V6)., Mean weekly basal insulin dose from week 50 to week 52 (V6)., Participant achieved individualised HbA1c target at week 52 (V6).

Source: https://euclinicaltrials.eu/ctis-public/view/2024-520068-32-00